EU clinical trial 2023-504655-27-00: A Phase 3 Randomized, Masked, Controlled Trial to Evaluate Efficacy and Safety of Belzupacap Sarotalocan (AU-011) Treatment Compared to Sham Control in Subjects with Primary Indeterminate Lesions or Small Choroidal Melanoma
Protocol code: AU-011-301
Sponsor: Aura Biosciences Inc. (Pharmaceutical company). Phase: Therapeutic confirmatory (Phase III). Countries: Czechia (ongoing, recruitment ended), Spain (ongoing, recruitment ended), Belgium (ongoing, recruitment ended), Italy (ongoing, recruitment ended), Austria (ongoing, recruitment ended), Germany (ongoing, recruitment ended), Denmark (ended), Greece (ended), Sweden (ended), Netherlands (ongoing, recruitment ended), France (ongoing, recruitment ended), Ireland (ended).
Therapeutic area(s): Diseases [C] - Neoplasms [C04]
Gender: Female, Male. Age: 18-64 years, 65+ years. Enrolment: 142.
Start date (EU): 2024-12-23. Decision date: 2024-05-20. Results received: No. Last updated: 2026-06-22.
Decision dates by country: SE: 2024-05-23, GR: 2024-05-23, IE: 2024-05-24, CZ: 2024-05-21, ES: 2024-05-20, FR: 2024-05-27, BE: 2024-05-27, DK: 2024-05-22, DE: 2024-05-21, IT: 2024-05-22, AT: 2024-05-23, NL: 2024-05-27

Condition(s): Primary Indeterminate Lesions or Small Choroidal Melanoma
Product: BELZUPACAP SAROTALOCAN, Placebo (Sham injection) to Belzupacap Sarotalocan solution for sham injection 0.0 mg/mL, BELZUPACAP SAROTALOCAN

Primary endpoint: Time to reach Tumor Progression (at the Week 65 analysis).
Endpoint(s): Time to reach the Composite Endpoint (at the Week 65 analysis). • Tumor progression or visual acuity failure

Source: https://euclinicaltrials.eu/ctis-public/view/2023-504655-27-00